EU clinical trial 2022-502343-35-00: A randomized, double-blind, placebo-controlled 2-way crossover study to assess the analgesic effects of THC in patients with chronic neuropathic pain and to phenotype the responders to THC treatment.
Protocol code: CHDR2220
Sponsor: Centre For Human Drug Research (Laboratory/Research/Testing facility). Phase: Therapeutic exploratory (Phase II). Countries: Netherlands (ongoing, recruiting).
Therapeutic area(s): Diseases [C] - Nervous System Diseases [C10]
Gender: Female, Male. Age: 18-64 years, 65+ years. Enrolment: 200.
Status: Ongoing, recruiting. Start date (EU): 2024-02-20. Decision date: 2022-12-15. Results received: No. Last updated: 2025-10-02.

Condition(s): Chronic neuropathic pain
Product: Placebo for Clinican THC 2% oil, Clinican THC 2% oil

Primary endpoint: • Pain severity NRS (measured daily), weekly average, • Experience sampling method (ESM) NRS pain scores
Endpoint(s): • Sleep quality (Pittsburgh Sleep Quality Index, or PSQI), • Sleep quality (Daily VAS), • Anxiety severity (HADS), • Depression severity (HADS), • Quality of Life questionnaire (SF36), • Drug effects questionnaire (DEQ), including VAS ‘Feeling high’ ‘Drug liking’ and VAS ‘Want more of the drug’, • Trial At Home (T@H) geospatial and phone usage tracking, • Treatment-emergent (serious) adverse events ((S)AEs) throughout the study at every study visit, • Concomitant medication throughout the study at every study visit, • Vital signs (Pulse Rate (bpm), Systolic blood pressure (mmHg), Diastolic blood pressure (mmHg)) as per assessment schedule, • Pain severity NRS (measured daily), weekly average

Source: https://euclinicaltrials.eu/ctis-public/view/2022-502343-35-00